EU clinical trial 2024-513002-60-00: A randomized, placebo-controlled, double-blind, multi-center, phase III trial to assess the efficacy and safety of trimodulin (BT588) in adult hospitalized subjects with CAP including COVID-19 pneumonia.
Protocol code: 1001
Sponsor: Biotest AG (Pharmaceutical company). Phase: Therapeutic confirmatory (Phase III). Countries: Belgium (ended), Austria (ended), Slovakia (ended), Germany (ended), Lithuania (ended), Hungary (ended), France (ended), Latvia (ended), Portugal (ended).
Therapeutic area(s): Diseases [C] - Respiratory Tract Diseases [C08]
Gender: Female, Male. Age: 18-64 years, 65+ years. Enrolment: 198.
Status: Ended. Start date (EU): 2022-10-26. End date (EU): 2025-02-04. End date: 2025-05-05. Decision date: 2024-07-16. Results received: Yes. Last updated: 2025-01-13.
Decision dates by country: LV: 2024-07-16, DE: 2024-07-16, SK: 2024-07-16, HU: 2024-07-17, PT: 2024-07-17, AT: 2024-07-22, LT: 2024-07-24, BE: 2024-07-18, FR: 2024-07-31

Condition(s): Non-severe community-acquired pneumonia (CAP) or moderate or severe Coronavirus Disease 2019 (COVID-19)
Product: Placebo is a solution for infusion of human albumin 1%, is an albumin preparation manufactured by dilution from the drug product of Albiomin 20%, it will be administrated via intravenous infusion., Trimodulin (human IgM, IgA, IgG solution)

Primary endpoint: Composite primary endpoint: Deterioration / mortality rate
Endpoint(s): Secondary efficacy endpoints: • Clinical deterioration rate (day 6-29) • Clinical deterioration rate (day 1-29) • 28-days all-cause mortality rate on day 29 • 90-days all-cause mortality rate on day 91 • Time to recovery to score ≤ 2 until day 29 • Proportion of subjects with score ≤ 2 on day 29 •Proportion of subjects improved, unchanged, and deteriorated/died compared to baseline at several days, Secondary safety endpoints: • Number, severity, causality, outcome, and seriousness of all adverse events (AEs), treatment-emergent AEs (TEAEs), AEs of special interest (AESIs), infusional TEAEs, TEAEs that led to permanent withdrawal of IMP, and TEAEs that led to discontinuation of the trial through day 29 [+3] • Number of all related TEAEs through day 29 [+3], Secondary PK endpoints: Changes from baseline, during and after treatment: - Serum concentration of IgM, IgA, and IgG, Secondary PD endpoints: Changes from baseline, during and after treatment: - Factors and markers of coagulation - Markers of inflammation - Complement factors - Biomarkers - Anti-SARS-CoV-2 and anti-S. pneumoniae titers

Source: https://euclinicaltrials.eu/ctis-public/view/2024-513002-60-00